EU clinical trial 2023-508154-25-00: Comparison of Vedolizumab treatment to Adalimumab dose intensification in Crohn’s disease patients with loss of response or biomarker activity to Adalimumab on first line with therapeutic drug concentration: A randomized, multicentre, controlled VEDIAN trial.
Protocol code: 23CH214
Sponsor: Centre Hospitalier Universitaire De Saint Etienne (Hospital/Clinic/Other health care facility). Phase: Therapeutic use (Phase IV). Countries: France (ongoing, recruiting).
Therapeutic area(s): Diseases [C] - Digestive System Diseases [C06]
Gender: Female, Male. Age: 18-64 years, 65+ years. Enrolment: 220.
Status: Ongoing, recruiting. Start date (EU): 2024-05-27. Decision date: 2024-01-05. Results received: No. Last updated: 2026-04-15.

Condition(s): Crohn's disease
Product: Entyvio 300 mg powder for concentrate for solution for infusion, Humira 20 mg solution for injection in pre-filled syringe

Primary endpoint: The primary objective will be to compare the proportion of clinical and biomarker remission (composite score) in the two groups of CD patients by 24 weeks after inclusion (ADA optimized versus Vedolizumab as second line).
Endpoint(s): Compare deep remission defined as clinical remission (clinical activity score < 150 with fecal calprotectin < 250 mcg/g stools and CRP < 5mg/L and either CDEIS <3 using ileocolonoscopy or Lewis score < 135 in the small bowel using VCE or no disease activity on MRE (defined by segmental Maria score < 7) or no bowel thickness on US according to the previous tools used at inclusion at W24., Compare treatment failure at W24 or W52 in the 2 groups, Compare the percentage of adverse events in both arms at W52, Symptomatic remission at W24 is a composite criterion measured by PRO2 defined as: Stool frequency (SF) < 3 with abdominal pain score (AP) < 2 at W24; AND absence of therapeutic failure between inclusion and W24., Compare evolution of IBDQ-32 in the two groups of patients between inclusion and W24, Compare rates of clinical and biomarker remission at W12, Compare rates of clinical and biomarker remission at W52, Mucosal remission at week 24 will be defined by: • A CDEIS score < 3 at week 24 using ileocolonoscopy; • OR a Lewis score < 135 at week 24 in the small intestine using VCE (video capsule endoscopy); • OR no ulceration using VCE at week 24; • OR no activity on MRI at week 24 (defined by a segmental Maria score < 7); • OR no intestinal thickening on ultrasound at week 24 (< 3 mm with no other signs of activity)., Analyze the CDST (clinical decision support tool) score for prediction of remission under vedolizumab and adalimumab optimization., Pharmacodynamic failure: Therapeutic blood ADA level (> 7.5 µg/mL) Pharmacokinetic failure: Subtherapeutic blood ADA level (< 7.5 µg/mL) Immunogenic failure (undetectable blood ADA level with presence of anti-ADA antibodies >50 ng/mL).

Source: https://euclinicaltrials.eu/ctis-public/view/2023-508154-25-00